EU clinical trial 2024-513728-40-00: CORTIFRENCH - Benefit of a flash dose of corticosteroids in digestive surgical oncology: a randomized, double blind, placebo-controlled trial
Protocol code: CORTIFRENCH
Sponsor: Centre Hospitalier Universitaire De Dijon (Hospital/Clinic/Other health care facility). Phase: Therapeutic confirmatory (Phase III). Countries: France (ongoing, recruitment ended).
Therapeutic area(s): Phenomena and Processes [G] - Immune system processes [G12]
Gender: Female, Male. Age: 18-64 years, 65+ years. Enrolment: 1200.
Status: Ongoing, recruitment ended. Start date (EU): 2019-07-02. Decision date: 2024-07-15. Results received: No. Last updated: 2026-01-16.

Condition(s): scheduled surgery for digestive cancer
Product: SOLUMEDROL 500 mg, poudre pour solution injectable, SODIUM CHLORIDE, METHYLPREDNISOLONE VIATRIS 500 mg, poudre pour solution injectable

Primary endpoint: frequency of patients with postoperative major complications occurring within 30 days after surgery (D30) and defined as all complications with Clavien-Dindo grade>2
Endpoint(s): Efficacy: - Overall survival at 3 years (time from surgery to death from any cause), Efficacy: Disease-free survival at 3 years (time from surgery to first documented progressive disease or death from any cause, whichever occurs first), Efficacy: Frequency of patients with postoperative infections occurring within 30 days after surgery and defined according to the CDC definitions, Efficacy: Frequency of patients with intraabdominal infections (including anastomotic fistula and intraabdominal abscess) within 30 days after surgery (CDC definition), Efficacy: Number of hospitalization days. In case of death, the patient will be considered as hospitalized until D30, Safety: frequency and type of side effects, particularly hyperglycemia and electrolyte disorders assessed by blood samples within the first 24 postoperative hours, and wound healing assessed by clinical inspection at the D30 follow-up

Source: https://euclinicaltrials.eu/ctis-public/view/2024-513728-40-00